EU clinical trial 2023-506117-22-00: A study to assess the effect of CC-95251 alone and in combination with anti-cancer drugs in subjects with Acute Myeloid Leukemia and Myelodysplastic Syndromes
Protocol code: CA059-001
Sponsor: Celgene Corp. (Pharmaceutical company). Phase: Human Pharmacology (Phase I)- Other. Countries: France (ended), Norway (ended), Italy (ended), Sweden (ended), Spain (ended).
Therapeutic area(s): Diseases [C] - Neoplasms [C04]
Gender: Female, Male. Age: 18-64 years, 65+ years. Enrolment: 153.
Status: Ended. Start date (EU): 2022-01-05. End date (EU): 2024-05-28. End date: 2024-07-30. Decision date: 2024-02-01. Results received: No. Last updated: 2024-08-28.
Decision dates by country: IT: 2024-02-05, NO: 2024-02-01, ES: 2024-02-06, FR: 2024-02-06, SE: 2024-02-01

Condition(s): Acute Myeloid Leukemia and Myelodysplastic Syndromes

Source: https://euclinicaltrials.eu/ctis-public/view/2023-506117-22-00